EU clinical trial 2022-502997-18-00: Single-dose Study of BMS-986326 at Two Dose Levels in Participants with Atopic Dermatitis
Protocol code: IM034-1014
Sponsor: Bristol-Myers Squibb Services Unlimited Company (Pharmaceutical company). Phase: Human Pharmacology (Phase I)- Other. Countries: Czechia (ended), Germany (ended), Spain (ended), France (ended), Poland (ended).
Therapeutic area(s): Diseases [C] - Skin and Connective Tissue Diseases [C17]
Gender: Female, Male. Age: 18-64 years, 65+ years. Enrolment: 64.
Status: Ended. Start date (EU): 2024-02-02. End date (EU): 2025-11-06. Decision date: 2023-09-11. Results received: No. Last updated: 2025-11-05.
Decision dates by country: ES: 2023-09-18, PL: 2023-09-18, FR: 2023-09-18, DE: 2023-09-14, CZ: 2023-09-11

Condition(s): Atopic Dermatitis

Source: https://euclinicaltrials.eu/ctis-public/view/2022-502997-18-00